EU clinical trial 2024-513857-55-00: Phase 2, Open-Label, Long-Term, Extension (OLE) Study of Infigratinib, an FGFR 1-3-Selective Tyrosine Kinase Inhibitor, in Children with Achondroplasia: PROPEL OLE
Protocol code: QBGJ398-203
Sponsor: Qed Therapeutics Inc. (Pharmaceutical company). Phase: Therapeutic exploratory (Phase II). Countries: France (ongoing, recruiting), Spain (ongoing, recruiting), Italy (ongoing, recruiting), Norway (ongoing, recruiting).
Therapeutic area(s): Diseases [C] - Musculoskeletal Diseases [C05]
Gender: Female, Male. Age: 0-17 years. Enrolment: 73.
Status: Ongoing, recruiting. Start date (EU): 2022-02-08. Decision date: 2024-09-11. Results received: No. Last updated: 2026-07-27.
Decision dates by country: NO: 2025-05-09, IT: 2025-04-28, ES: 2024-09-11, FR: 2024-09-27

Condition(s): Achondroplasia
Product: INFIGRATINIB, INFIGRATINIB, INFIGRATINIB, INFIGRATINIB, Infigratinib

Primary endpoint: Incidence of treatment emergent adverse events (TEAE) and serious TEAE, Changes over time in height Z-score in relation to ACH and non-ACH growth charts.
Endpoint(s): Change over time in absolute height velocity, expressed as height velocity Z-score in relation to ACH and non-ACH growth charts., Changes over time in body proportions, Changes over time in weight Z-score, Changes over time in BMI, Age of puberty onset and time to Tanner stage ≥4., Changes over time in number of episodes of otitis media per year., Changes over time in number of episodes and/or severity of sleep apnea., Changes over time in range of motion (elbow)., Changes over time in skeletal abnormalities of the lower extremities and spine, Changes in health-related quality of life (HRQoL) as assessed by Pediatric Quality of Life Inventory (PedsQL), Changes in health-related quality of life (HRQoL) as assessed by Quality of Life in Short Stature Youth questionnaire (QoLISSY), Overall pain as assessed by Numeric Rating Scale for pain (Pain-NRS), Changes in functional abilities as evaluated by Functional Independence Measure for Children (WeeFIM), Severity of the physical functioning challenges as assessed by Patient/Parent Global Impression of Severity (PGI-S), Severity of the physical functioning challenges as assessed by Patient/Parent Global Impression of Change (PGI-C), Subject and caregiver evaluation of treatment benefit as assessed by a qualitative interview, Changes in cognitive functions assessed by age-appropriate computerized tests

Source: https://euclinicaltrials.eu/ctis-public/view/2024-513857-55-00